EU clinical trial 2022-502787-20-00: Phase II, multi‑cohort trial of neoadjuvant and post‑surgery IO102‑IO103 and pembrolizumab in patients with selected resectable tumors
Protocol code: IOB‑032/PN‑E40
Sponsor: IO Biotech ApS (Pharmaceutical company). Phase: Therapeutic exploratory (Phase II). Countries: Spain (ended), Germany (ended), Denmark (ended), France (ended).
Therapeutic area(s): Diseases [C] - Neoplasms [C04]
Gender: Female, Male. Age: 18-64 years, 65+ years. Enrolment: 65.
Status: Ended. Start date (EU): 2023-09-28. End date (EU): 2026-01-28. End date: 2026-01-29. Decision date: 2023-08-23. Results received: No. Last updated: 2025-03-26.
Decision dates by country: FR: 2023-08-25, DE: 2023-08-23, DK: 2023-08-23, ES: 2023-08-23

Condition(s): Melanoma and squamous cell carcinoma of the head and neck
Product: IO102-IO103, KEYTRUDA 25 mg/mL concentrate for solution for infusion

Primary endpoint: MPR, defined as pCR (0% residual viable tumor) or near pCR (≤10% residual viable tumor) at surgery (central assessment)
Endpoint(s): pCR (0% residual viable tumor) at surgery (central assessment), Pathological response rate (% of patients with pPR, near pCR or pCR) (central assessment), ORR, determined by RECIST 1.1, at the end of neoadjuvant treatment (investigator assessment), EFS from the start of neoadjuvant treatment (investigator assessment), DFS from the date of surgery (investigator assessment), Safety endpoints • Incidence of adverse events (AEs) • Incidence of serious adverse events (SAEs) • Incidence of treatment-related AEs • Incidence of treatment-related SAEs • Incidence of AEs leading to discontinuation of trial treatment

Source: https://euclinicaltrials.eu/ctis-public/view/2022-502787-20-00